EU clinical trial 2024-513640-29-00: Primary and booster meningococcal vaccination in Dutch elderly: study to investigate the immune response and determine functional antibodies after the tetravalent MenACWY-TT conjugate vaccine in the elderly population
Protocol code: IIV-407
Sponsor: Rijksinstituut voor Volksgezondheid en Milieu (RIVM) (Hospital/Clinic/Other health care facility). Phase: Therapeutic use (Phase IV). Countries: Netherlands (ongoing, recruitment ended).
Therapeutic area(s): Diseases [C] - Bacterial Infections and Mycoses [C01]
Gender: Female, Male. Age: 65+ years. Enrolment: 280.
Status: Ongoing, recruitment ended. Start date (EU): 2024-05-13. Decision date: 2024-05-13. Results received: No. Last updated: 2025-10-27.

Condition(s): Invasive meningococcal disease, sepsis, meningitis
Product: Nimenrix powder and solvent for solution for injection in pre-filled syringe Meningococcal groups A, C, W-135 and Y conjugate vaccine

Primary endpoint: Functional antibody levels against MenA, MenC, MenW and MenY are measured using the serum bactericidal antibody (SBA) assay.
Endpoint(s): To compare SBA levels of ≥8 (persistence of vaccine induced protective antibody levels) at 1 month and 1 year within the two age groups and 1 month and 1 year after the booster vaccination in the booster-subcohort, To determine serum MenA-PS, MenC-PS, MenW-PS and MenY-PS specific IgG levels at 1 month and 1 year and compare between the two age groups and 1 month and 1 year after the booster vaccination in the booster-subcohort, To determine serum IgG antibody levels against tetanus, the carrier protein for both vaccines, at 1 month and 1 year and compare within the two age groups and 1 month and 1 year after the booster vaccination in the booster-subcohort, To determine serum IgA and IgM levels against MenA, MenC, MenW and MenY at 1 month and 1 year and compare between the two age groups and 1 month and 1 year after the booster vaccination in the booster-subcohort, To determine MenC-PS specific IgG subclasses (IgG1/IgG2 ratio) and avidity at 1 month and 1 year and compare between the two age groups and 1 month and 1 year after the booster vaccination in the booster-subcohort, To determine long-term persistence of functional serum antibody (IgG, IgA and IgM) titers (GMTs)/levels (GMCs) 5 years after primary vaccination, To determine salivary MenA-PS, MenC-PS, MenW-PS and MenY-PS-specific IgG, IgA and IgM levels after primary and booster vaccination., To compare the serum MenA-Ps, MenC-PS, MenW-PS and MenY-PS specific IgG, IgA and IgM levels and SBA titers from this study to the results found in the StimulAge study (NL48510.100.14), To compare the salivary MenA-Ps, MenC-PS, MenW-PS and MenY-PS specific IgG, IgA and IgM levels from this study to the results found in the StimulAge study (NL48510.100.14)

Source: https://euclinicaltrials.eu/ctis-public/view/2024-513640-29-00